EU clinical trial 2024-518858-17-00: The MAVRiC Study: A Phase II Study of Disease Risk Mutation-guided Finite Duration Acalabrutinib plus Venetoclax for Relapse in CLL/SLL after First-line Finite covalent BTKi plus BCL2i combination, with or without Obinutuzumab
Protocol code: D8220C00036
Sponsor: AstraZeneca AB (Pharmaceutical company). Phase: Therapeutic exploratory (Phase II). Countries: Italy (authorised, recruiting), Austria (authorised, recruiting), Spain (authorised, recruiting), Ireland (ongoing, recruiting), Czechia (authorised, recruitment pending), Poland (authorised, recruitment pending).
Therapeutic area(s): Diseases [C] - Neoplasms [C04]
Gender: Female, Male. Age: 18-64 years, 65+ years. Enrolment: 63.
Start date (EU): 2026-05-22. Decision date: 2026-04-27. Results received: No. Last updated: 2026-07-20.
Decision dates by country: AT: 2026-04-30, CZ: 2026-04-29, IE: 2026-05-01, IT: 2026-05-04, ES: 2026-04-27, PL: 2026-04-30

Condition(s): Chronic Lymphocytic Leukemia/Small Lymphocytic Lymphoma (CLL/SLL)
Product: Venclyxto 100 mg film-coated tablets, Venclyxto 100 mg film-coated tablets, Venclyxto 10 mg film-coated tablets, Venclyxto 100 mg film-coated tablets, Venclyxto 50 mg film-coated tablets, Calquence 100 mg film-coated tablets

Primary endpoint: ORR, defined as the proportion of participants who achieve best response of complete remission (CR), complete remission with incomplete bone marrow recovery (CRi), nodular partial remission (nPR), or partial remission (PR) per International Workshop on Chronic Lymphocytic Leukemia (iwCLL) criteria (Hallek et al, 2018) as assessed by the investigator, with timepoint of primary interest after completion of Cycle 14.
Endpoint(s): 1) Efficacy: PFS, defined as time from date of the first dose until progression per iwCLL criteria (Hallek et al, 2018) as assessed by the investigator, or death due to any cause in the absence of progression. The measure of interest is the median of PFS., 2) Efficacy: DoR, defined as the time from the date of first documented response until date of documented progression per iwCLL criteria (Hallek et al, 2018) as assessed by the investigator, or death due to any cause. The measure of interest is the median of DoR., 3) Efficacy: EFS, defined as the time from date of the first dose until the first occurrence of disease progression, initiation of subsequent CLL/SLL therapy, or death due to any cause. The measure of interest is the median of EFS., 4) Efficacy: TTNT, defined as the time from date of the first dose to the initiation of subsequent CLL/SLL therapy or death due to any cause. The measure of interest is the median of TTNT, 5) Efficacy: OS, defined as the time from date of the first dose until the date of death due to any cause. The timepoint of interest is the landmark estimate of OS at 5 years., 6) Efficacy: Rate of peripheral blood (PB) uMRD, defined as proportion of participants achieving remission based on a clonoSEQ® assay result of < 1 CLL cell per 100,000 leukocytes (< 10^-5). The timepoint of interest is the rate of uMRD at 3 months after last treatment dose, 7) Safety: Safety and tolerability will be evaluated in terms of adverse event (AE)s/serious adverse event (SAE)s, AEs leading to treatment discontinuation and deaths, event(s) of clinical interest (ECI)s and relevant clinical laboratory results

Source: https://euclinicaltrials.eu/ctis-public/view/2024-518858-17-00